EU clinical trial 2022-501067-40-00: A Phase 3, Multicenter, Open-label, Basket, Long-term Extension Study of Ustekinumab in Pediatric Clinical Study Participants (2 to <18 Years of Age)
Protocol code: CNTO1275ISD3001
Sponsor: Janssen - Cilag International (Pharmaceutical company). Phase: Therapeutic confirmatory (Phase III). Countries: Hungary (ongoing, recruitment ended), France (ended), Germany (ended), Poland (ongoing, recruitment ended), Belgium (ended), Spain (ended), Italy (ongoing, recruitment ended).
Therapeutic area(s): Phenomena and Processes [G] - Immune system processes [G12]
Gender: Female, Male. Age: 0-17 years. Enrolment: 83.
Start date (EU): 2021-11-30. Decision date: 2023-03-31. Results received: No. Last updated: 2026-06-17.
Decision dates by country: BE: 2023-04-27, FR: 2023-03-31, DE: 2023-04-26, PL: 2023-05-05, ES: 2024-08-29, HU: 2023-04-03, IT: 2024-08-20

Condition(s): Moderately to Severely Active Ulcerative Colitis, Juvenile Psoriatic Arthritis, Moderately to Severely Active Crohn's Disease
Product: STELARA 45 mg solution for injection, STELARA 90 mg solution for injection in pre-filled syringe

Primary endpoint: AEs, SAEs, AEs leading to discontinuation of study intervention, and AEs of special interest (as determined for each indication)., Clinical laboratory hematology and chemistry., Injection-site reactions, AEs of worsening of the disease under study., An addition of concomitant therapy due to loss of response.

Source: https://euclinicaltrials.eu/ctis-public/view/2022-501067-40-00